EU clinical trial 2024-512681-34-00: Pharmacokinetics of a novel extended infusion regimen of fosfomycin
Sponsor: Medical University Of Vienna (Educational Institution). Phase: Human Pharmacology (Phase I)- Other. Countries: Austria (ongoing, recruiting).
Therapeutic area(s): Diseases [C] - Bacterial Infections and Mycoses [C01]
Gender: Female, Male. Age: 18-64 years, 65+ years. Enrolment: 18.
Status: Ongoing, recruiting. Start date (EU): 2018-06-04. Decision date: 2024-04-23. Results received: No. Last updated: 2024-04-23.

Condition(s): Healthy volunteers and critically ill patients

Source: https://euclinicaltrials.eu/ctis-public/view/2024-512681-34-00